EU clinical trial 2026-526307-30-00: A study to compare how 2 different formulations of survodutide are taken up in the body when given by injection in healthy men and women with and without overweight or obesity
Protocol code: 1404-0145
Sponsor: Boehringer Ingelheim International GmbH (Pharmaceutical company). Phase: Human Pharmacology (Phase I)- Bioequivalence Study. Countries: Germany (authorised, recruitment pending).
Therapeutic area(s): Not possible to specify
Gender: Female, Male. Age: 18-64 years. Enrolment: 44.
Status: Authorised, recruitment pending. Decision date: 2026-07-08. Results received: No. Last updated: 2026-07-08.

Condition(s): Healthy

Source: https://euclinicaltrials.eu/ctis-public/view/2026-526307-30-00